EU clinical trial 2024-519705-36-00: Treatment of Osteogenesis Imperfecta with Parathyroid hormone and Zoledronic acid
Protocol code: Version 12.0
Sponsor: University Of Edinburgh, NHS Lothian (Educational Institution, Hospital/Clinic/Other health care facility). Phase: Therapeutic use (Phase IV). Countries: France (ended), Ireland (ended), Netherlands (ended), Denmark (ended).
Therapeutic area(s): Phenomena and Processes [G] - Musculoskeletal and Neural Physiological Phenomena [G11]
Gender: Female, Male. Age: 18-64 years, 65+ years. Enrolment: 57.
Status: Ended. Start date (EU): 2019-03-26. End date (EU): 2025-03-21. Decision date: 2024-12-17. Results received: Yes. Last updated: 2025-01-23.
Decision dates by country: DK: 2025-01-02, FR: 2024-12-20, IE: 2024-12-17, NL: 2025-01-23

Condition(s): Osteogenesis imperfecta
Product: Alendronic Acid 70 mg tablets, FORSTEO 20 micrograms/80 microliters solution for injection in pre-filled pen, Risedronate Sodium 35 mg Film-coated Tablets, Zoledronic Acid Seacross 5 mg/100ml solution for infusion, Fultium-D3 800 IU Capsules, Ibandronic acid Accord 3 mg solution for injection in pre-filled syringe, Disodium Pamidronate 15mg/ml Concentrate for Solution for Infusion, Prolia 60 mg solution for injection in pre-filled syringe, Calcichew-D3 500 mg/200 IU Chewable Tablet, Ibandronic acid Sandoz 150 mg Film-coated Tablets, CLASTEON® 400mg capsules

Primary endpoint: The proportion of participants experiencing a clinical fracture validated by x-ray or other imaging, This is an event driven study which will be terminated when 139 participants have experienced an incident clinical fracture validated by x-ray or other imaging. This is expected to have occurred after an average of 62 months follow up.
Endpoint(s): The total number of clinical fractures experienced by participants validated by x-ray or other imaging., The number of incident vertebral fractures assessed by imaging of the thoracic and lumbar spine., The total number of fractures experienced by participants defined as the combination validated clinical fractures and vertebral fractures and fractures reported by participants, where imaging was not performed, not feasible or where the results were inconclusive., Bone pain assessed by the brief pain inventory (BPI); quality of life as assessed by the SF36 questionnaire; functional status as assessed by the health assessment questionnaire (HAQ) and EuroQol5D (EQ5D) assessment tools, and adverse events, The total number of clinical fractures validated by imaging, incident vertebral fractures, and total number of fractures will be evaluated at the same time as the primary endpoint which on average will be after an average duration of 62 months follow up, Bone pain, health related quality of life and functional status will be evaluated after 12 months, 24 months and at the end of study (approximately 62 months)

Source: https://euclinicaltrials.eu/ctis-public/view/2024-519705-36-00